EU clinical trial 2024-513576-18-00: Induction chemotherapy followed by standard concurrent chemoradiotherapy in cervical cancer with para-aortic lymph node involvement: A phase III, multicenter, parallel-group randomized, controlled trial - ONCOCOL-01
Protocol code: RC31/17-0213
Sponsor: Centre Hospitalier Universitaire De Toulouse (Hospital/Clinic/Other health care facility). Phase: Therapeutic confirmatory (Phase III). Countries: France (temporarily halted).
Therapeutic area(s): Diseases [C] - Female Urogenital Diseases and Pregnancy Complications [C13]; Phenomena and Processes [G] - Reproductive and Urinary Physiological Phenomena [G08]
Gender: Female. Age: 18-64 years, 65+ years. Enrolment: 310.
Status: Temporarily halted. Start date (EU): 2020-07-17. Decision date: 2024-05-28. Results received: No. Last updated: 2024-08-12.

Condition(s): Cervical Cancer
Product: PACLITAXEL KABI 6 mg/ml, solution à diluer pour perfusion., Carboplatin Accord Healthcare 10 mg/ml, solution à diluer pour de perfusion

Primary endpoint: Overall survival defined as the time from the date of randomization to the date of death from any cause
Endpoint(s): Tumour response at the end of standard treatment (concurrent chemoradiotherapy), based on investigator assessments according to both RECIST 1.1 and PERCIST 1.0 criteria, Progression-free survival, defined as the time from the date of randomization to the date of progression (based on investigator assessments according to RECIST 1.1 criteria) or the date of death from any cause, whichever occurs first, Site of disease recurrence (local, pelvic and/or para-aortic lymph nodes, distant), Health-related quality of life, assessed using the EORTC QLQ-C30 questionnaire and the QLQ-CX24 module, Adverse events occurring from the first study treatment administration, assessed based on the NCI-CTCAE version 5.0

Source: https://euclinicaltrials.eu/ctis-public/view/2024-513576-18-00